EU clinical trial 2023-510232-36-00: Study on PhArmacokiNetics of first liNe Antiretrovirals in healthy Breastfeeding volunteers or women living with HIV and already on antiretrovirals
Protocol code: 114041
Sponsor: Stichting Radboud University Medical Center (Patient organisation/association). Phase: Human Pharmacology (Phase I)- Other. Countries: Netherlands (ended).
Therapeutic area(s): Diseases [C] - Virus Diseases [C02]
Gender: Female. Age: 18-64 years. Enrolment: 20.
Status: Ended. Start date (EU): 2024-10-01. End date (EU): 2025-04-28. Decision date: 2024-09-12. Results received: No. Last updated: 2025-07-03.

Condition(s): healthy breastfeeding women

Source: https://euclinicaltrials.eu/ctis-public/view/2023-510232-36-00